EU clinical trial 2024-518589-29-00: A Phase III, randomized, double-blind, placebo-controlled study to assess the efficacy, safety, and tolerability of BI 1291583 2.5 mg administered once daily for up to 76 weeks in patients with bronchiectasis (The AIRTIVITY TM Study)
Protocol code: 1397-0014
Sponsor: Boehringer Ingelheim International GmbH, Boehringer Ingelheim Espana S.A. (Pharmaceutical company). Phase: Therapeutic confirmatory (Phase III). Countries: Poland (ongoing, recruitment ended), Romania (ongoing, recruitment ended), Belgium (ongoing, recruiting), Finland (ongoing, recruitment ended), Germany (ongoing, recruiting), Croatia (ongoing, recruitment ended), France (ongoing, recruiting), Bulgaria (ongoing, recruitment ended), Hungary (ongoing, recruitment ended), Sweden (ongoing, recruitment ended), Greece (ended), Lithuania (ongoing, recruitment ended), Portugal (ongoing, recruitment ended), Italy (ongoing, recruiting), Netherlands (ongoing, recruitment ended), Czechia (ongoing, recruitment ended), Denmark (ongoing, recruiting), Austria (ongoing, recruiting), Latvia (ongoing, recruitment ended), Slovakia (ongoing, recruitment ended), Ireland (ongoing, recruitment ended), Spain (ongoing, recruiting).
Therapeutic area(s): Diseases [C] - Respiratory Tract Diseases [C08]
Gender: Female, Male. Age: 0-17 years, 18-64 years, 65+ years. Enrolment: 534.
Start date (EU): 2025-08-21. Decision date: 2025-07-31. Results received: No. Last updated: 2026-04-20.
Decision dates by country: GR: 2025-08-05, SE: 2025-08-01, HU: 2025-08-07, IT: 2025-08-01, DK: 2025-08-01, IE: 2025-08-08, LT: 2025-08-05, SK: 2025-08-04, BE: 2025-07-31, HR: 2025-08-11, FR: 2025-08-01, RO: 2025-08-11, FI: 2025-08-01, ES: 2025-08-13, NL: 2025-08-06, AT: 2025-08-04, PT: 2025-08-01, LV: 2025-08-04, CZ: 2025-08-04, PL: 2025-08-11, BG: 2025-08-05, DE: 2025-08-01

Condition(s): Bronchiectasis
Product: Placebo matching BI 1291583, BI 1291583

Primary endpoint: Annualised rate of adjudicated pulmonary exacerbations (number of events per person year) up to Week 76.
Endpoint(s): Absolute change from baseline in post-bronchodilator FEV1 %pred at Week 52, Absolute change from baseline in QOL-B respiratory symptoms domain score at Week 52 (participants ≥16 years), Time to first adjudicated pulmonary exacerbation up to Week 76, Absolute change from baseline in post-bronchodilator FVC %pred at Week 52, Annualised rate of severe adjudicated pulmonary exacerbations up to Week 76, Time to first severe adjudicated pulmonary exacerbation up to Week 76

Source: https://euclinicaltrials.eu/ctis-public/view/2024-518589-29-00